EU clinical trial 2022-500090-13-00: A Phase 2 Randomized, Double-blind, Placebo-controlled Study to Evaluate the Effect of EDG-5506 on Safety, Biomarkers, Pharmacokinetics, and Functional Measures in Adults and Adolescents with Becker Muscular Dystrophy
Protocol code: EDG-5506-201
Sponsor: Edgewise Therapeutics Inc. (Pharmaceutical company). Phase: Therapeutic exploratory (Phase II). Countries: Netherlands (ended), Belgium (ended), Germany (ongoing, recruitment ended), Spain (ongoing, recruitment ended), France (ongoing, recruitment ended), Denmark (ended), Italy (ongoing, recruitment ended).
Therapeutic area(s): Diseases [C] - Congenital, Hereditary, and Neonatal Diseases and Abnormalities [C16]; Diseases [C] - Musculoskeletal Diseases [C05]
Gender: Male. Age: 18-64 years. Enrolment: 81.
Start date (EU): 2022-12-29. Decision date: 2022-10-20. Results received: No. Last updated: 2026-05-06.
Decision dates by country: DK: 2024-02-26, DE: 2024-02-21, FR: 2024-03-22, IT: 2024-03-27, ES: 2024-02-13, NL: 2022-10-20, BE: 2024-02-16

Condition(s): Becker Muscular Dystrophy (BMD)
Product: Test IMP (EDG-5506) without active substance, EDG-5506

Primary endpoint: 1. Cohorts 1 and 2: Incidence, frequency, and severity of adverse events (AEs) and serious adverse events (SAEs) during treatment with sevasemten or placebo., 2. Cohorts 1 and 2: Change from Baseline in serum creatine kinase (CK) averaged across months 6, 9 and 12., 3. Cohorts 4 and 5: Incidence, frequency, and severity of adverse events (AEs) and serious adverse events (SAEs) during treatment with sevasemten or placebo, 4. Cohort 6: Month 18 change from Baseline in total North Star Ambulatory Assessment (NSAA) score, 5. Cohort 6: Incidence, frequency, and severity of adverse events (AEs) and serious adverse events (SAEs) during treatment with sevasemten or placebo
Endpoint(s): 1. Cohorts 1 and 2: Month 12 change from Baseline in total North Star Ambulatory Assessment (NSAA) score., 2. Cohorts 1 and 2: Cumulative loss of function on the NSAA over 12 months, 3. Cohorts 1 and 2: Month 12 Change from Baseline in: − Total North Star Assessment for Limb Girdle Muscular Dystrophies (NSAD) score − 10-meter walk/run − 100-meter timed test, 4. Cohorts 1 and 2: • Change from Baseline in serum myoglobin averaged across Months 6, 9, and 12 • Change from Baseline in TNNI2 averaged across Months 6 and 12, 5. Cohorts 1 and 2: Pharmacokinetics (PK) of sevasemten as measured by steady state (Css) plasma concentration of sevasemten., 6. Cohorts 1 and 2: Incidence of treatment-emergent abnormal laboratory test results (clinical chemistry, hematology, coagulation). Change from Baseline in: − Safety laboratory parameters − Vital signs − Electrocardiogram (ECG) parameters − Cardiac function as assessed by an echocardiogram − Pulmonary function as assessed by forced expiratory volume in 1 second (FEV1) , forced vital capacity (FVC), 7. Cohorts 4 and 5: Pharmacokinetics (PK) of sevasemten as measured by steady state (Css) plasma concentration of sevasemten., 8. Cohorts 4 and 5: Incidence of treatment-emergent abnormal laboratory test results (clinical chemistry, hematology, coagulation). Change from Baseline in: − Safety laboratory parameters − Vital signs − Electrocardiogram (ECG) parameters − Cardiac function as assessed by an echocardiogram − Pulmonary function as assessed by forced expiratory volume in 1 second (FEV1) , forced vital capacity (FVC) − Growth (as assessed by height centile on WHO growth charts), 9. Cohort 6: Month 18 change from Baseline in: - 100-meter timed test - 10-meter walk/run - Stride velocity (95th percentile) -Total North Star Assessment for Limb-Girdle Type Muscular Dystrophies (NSAD) score, 10. Cohort 6: Month 18 change from Baseline in fat fraction of upper leg muscles (as assessed by MRI), 11. Cohort 6: Pharmacokinetics (PK) of sevasemten as measured by steady state (Css) plasma concentration of sevasemten, 12. Cohort 6: Incidence of treatment-emergent abnormal laboratory test results (clinical chemistry, hematology, coagulation). Change from Baseline in: − Safety laboratory parameters − Vital signs − Electrocardiogram (ECG) parameters − Cardiac function as assessed by an echocardiogram − Pulmonary function as assessed by forced expiratory volume in 1 second (FEV1) , forced vital capacity (FVC), 13. Cohort 6: Month 18 change from Baseline in: - Serum Creatine kinase (CK) - Fast skeletal muscle troponin I (TNNI2). - Serum myoglobin, 14. Cohort 6: Cumulative loss of function on the North Star Ambulatory Assessment (NSAA) over 18 months

Source: https://euclinicaltrials.eu/ctis-public/view/2022-500090-13-00